EU clinical trial 2025-523267-38-00: Effectiveness of Trazodone on Emotional Blunting in Patients with Major Depressive: a Phase IV, Open-label, clinical study
Protocol code: 039(Z)MD25052
Sponsor: Angelini Pharma Italia Aziende Chimiche Riunite Angelini Francesco A.C.R.A.F. S.p.A. Enunciabile Anche Angelini Pharma Italia S.p.A. Angelini Pharma S.p.A. A.C.R.A.F. S.p.A. Acraf S.p.A. Angelini S.p.A. aziende Chimiche Riunite Angelini Francesco A.C.R.A.F. S.p.A. (Pharmaceutical company). Phase: Therapeutic use (Phase IV). Countries: Bulgaria (authorised, recruitment pending), Poland (authorised, recruitment pending), Hungary (authorised, recruitment pending).
Therapeutic area(s): Psychiatry and Psychology [F] - Mental Disorders [F03]
Gender: Female, Male. Age: 18-64 years. Enrolment: 120.
Status: Authorised, recruitment pending. Decision date: 2026-07-29. Results received: No. Last updated: 2026-08-03.
Decision dates by country: BG: 2026-08-03, HU: 2026-07-30, PL: 2026-07-29

Condition(s): Major depressive disorder (MDD)
Product: Trittico AC 150 mg retard tabletta, TRITTICO CR, 75 mg, tabletki o przedłużonym uwalnianiu, ТРИТИКО 150 mg таблетки с удължено освобождаване, ТРИТИКО 75 mg таблетки с удължено освобождаване, TRITTICO CR, 150 mg, tabletki o przedłużonym uwalnianiu

Primary endpoint: During the study, participants will record the answers given to a questionnaire designed to measure emotional experiences, called Oxford Depression Questionnaire (ODQ). The outcome will be measured by the changes in the score recorded at the beginning of patients’ participation compared to the one after 8 weeks of treatment.
Endpoint(s): Other parameters evaluated will be the evolution of depression and the effect on cognition, sleep, and overall quality of life. The effect of the treatment on functioning at work or school, in social situations, or with family and home responsibilities will be also assessed using scales and questionnaires designed for these purposes.

Source: https://euclinicaltrials.eu/ctis-public/view/2025-523267-38-00